EU clinical trial 2022-502903-31-00: A prospective multi-centric, randomised, double-dummy, double- blind, placebo-controlled 3-way Phase III study to investigate the efficacy and safety of two dexamfetamine sulfate formulations in adults with ADHD - DEXINA -
Protocol code: 6520-9970-08
Sponsor: Medice Arzneimittel Puetter GmbH & Co. KG (Pharmaceutical company). Phase: Therapeutic confirmatory (Phase III). Countries: Germany (ongoing, recruitment ended).
Therapeutic area(s): Diseases [C] - Nervous System Diseases [C10]; Psychiatry and Psychology [F] - Psychological Phenomena [F02]
Gender: Female, Male. Age: 18-64 years, 65+ years. Enrolment: 380.
Status: Ongoing, recruitment ended. Start date (EU): 2026-07-28. Decision date: 2024-03-22. Results received: No. Last updated: 2026-07-29.
Decision dates by country: DE: 2024-04-30

Condition(s): Patients with ADHD (according to ICD-10 / DSM-5)
Product: Placebo for test 2 - 10 mg, Placebo for test 2 - 15 mg, Placebo for test 1 - 10 mg, Placebo for Test 1 - 5 mg, Dexamfetamine sulfate 20 mg modified-release capsule, Attentin 5 mg, Tablette, Attentin 10 mg Tablette, Dexamfetamine sulfate 15 mg modified-release capsule, Placebo for test 2 - 20 mg, Dexamfetamine sulfate 10 mg modified-release capsule

Primary endpoint: The two primary endpoint families will be tested in hierarchical order separately for the respectiv test of • DEX IR tablets versus Placebo • DEX XL capsules versus Placebo, 1.1a Change in the total score of the ADHS-DC-Q at the end of the Optimal Stable Dose Phase (Visit 5) compared to baseline (Visit 0), 1.1b Change in the total score of the SDS at the end of the Optimal Stable Dose Phase (Visit 5) compared to baseline (Visit 0), 1.2 Treatment failure defined as:- Percentage change of at least 30% in the total score of the ADHS-DC-Q scale at the end of the LTFU / Withdrawal Phase compared to the beginning of the LTFU / Withdrawal Phase (Visit 5) - 2. Percentage change greater than -30% in the total score of the ADHS-DC-Q scale at the end of the LTFU / Withdrawal Phase (Visit 9) compared to baseline (Visit 0)
Endpoint(s): CGI-I Score at the end of the Optimal Stable Dose Phase (Visit 5), Change in CGI-S Score at the end of the Optimal Stable Dose Phase (Visit 5) and EOT (Visit 9) compared to baseline (Visit 0)

Source: https://euclinicaltrials.eu/ctis-public/view/2022-502903-31-00